EU clinical trial 2026-525421-20-00: An open label, balanced, randomized, single dose, two-treatment, two period, two-sequence, crossover, bioequivalence study comparing Fexofenadine HCl and Pseudoephedrine HCl Extended Release Tablet 180 mg/240 mg, Manufactured by: Sun Pharmaceutical Industries Limited, India with Allegra-D® 24 HR (Fexofenadine HCl and Pseudoephedrine HCl Extended Release Tablets 180 mg + 240 mg) tablets, Distributed by: Chattem Inc., a Sanofi Company Chattanooga, TN 37409-0219, USA, in healthy, adult, human participants under fed conditions.
Protocol code: FEXOP-17-25
Sponsor: Sun Pharmaceutical Industries Limited (Pharmaceutical company). Phase: Human Pharmacology (Phase I)- Bioequivalence Study. Countries: Romania (authorised, recruitment pending).
Therapeutic area(s): Diseases [C] - Immune System Diseases [C20]
Gender: Female, Male. Age: 18-64 years. Enrolment: 48.
Status: Authorised, recruitment pending. Decision date: 2026-07-01. Results received: No. Last updated: 2026-07-01.

Condition(s): Seasonal allergic rhinitis

Source: https://euclinicaltrials.eu/ctis-public/view/2026-525421-20-00